EU clinical trial 2024-519170-39-00: Exploiting the synergistic effect of PARP inhibition with cisplatin and hyperthermia during interval cytoreductive surgery and HIPEC in ovarian cancer: The PROOV study - A Phase I/II clinical trial
Sponsor: Het Nederlands Kanker Instituut-Antoni van Leeuwenhoek Ziekenhuis Stichting (Hospital/Clinic/Other health care facility). Phase: Phase I and Phase II (Integrated)- Other. Countries: Netherlands (ongoing, recruiting).
Therapeutic area(s): Diseases [C] - Neoplasms [C04]
Gender: Female. Age: 18-64 years, 65+ years. Enrolment: 55.
Status: Ongoing, recruiting. Start date (EU): 2025-04-07. Decision date: 2025-04-07. Results received: No. Last updated: 2025-04-07.

Condition(s): fallopian tube cancer, ovarian cancer, extraovarian cancer

Source: https://euclinicaltrials.eu/ctis-public/view/2024-519170-39-00